EU clinical trial 2024-518643-38-00: Adipose-derived mesenchymal stem cells as local treatment of ulcerative colitis
Sponsor: Region Midtjylland (Hospital/Clinic/Other health care facility). Phase: Phase I and Phase II (Integrated)- Other. Countries: Denmark (ended).
Therapeutic area(s): Diseases [C] - Digestive System Diseases [C06]
Gender: Female, Male. Age: 18-64 years, 65+ years. Enrolment: 16.
Status: Ended. Start date (EU): 2023-06-30. End date (EU): 2025-10-22. Decision date: 2024-11-11. Results received: No. Last updated: 2024-11-11.

Condition(s): ulcerative colitis
Product: MSC, adipose tissue, MSC, adipose tissue, MSC, adipose tissue, Natriumklorid ”B. Braun”, MSC, adipose tissue, Natriumklorid Fresenius Kabi 9 mg/ml

Primary endpoint: Reduced inflammatory activity assessed with endoscopic Mayoscore 14 days after treatment with injection of allogeneic adipose-derived mesenchymal stem cells.
Endpoint(s): Reduced inflammatory activity assessed with endoscopic Mayoscore 4, 7, 14 and 30 days after treatment., Improvement in histological grading of inflammation in tissue samples day 4, 7, 14 and 30 after treatment., Improvement in symptoms 4, 7, 14 and 30 days after treatment assessed by complete Mayoscore, Complications/adverse events during the treatment in relation to dose seeking, Demonstrate the formation or absence of HLA antibodies, corresponding to the donor's HLA type, as a result of the treatment., Demonstrate differences between the ability of mesenchymal stem cells from different donors to immunomodulation using potency assays.

Source: https://euclinicaltrials.eu/ctis-public/view/2024-518643-38-00